EU clinical trial 2023-508050-26-00: A Phase Ib study of Vyxeos® (liposomal daunorubicin and cytarabine) in combination with Clofarabine in children with relapsed/refractory AML
Protocol code: SP_MH20VYX
Sponsor: Prinses Maxima Centrum voor Kinderoncologie B.V. (Hospital/Clinic/Other health care facility). Phase: Human Pharmacology (Phase I)- Other. Countries: Netherlands (ongoing, recruiting), Austria (ongoing, recruiting), Italy (ongoing, recruiting), Germany (ongoing, recruiting), Spain (ongoing, recruiting), Denmark (ongoing, recruiting).
Therapeutic area(s): Diseases [C] - Neoplasms [C04]
Gender: Female, Male. Age: 0-17 years, 18-64 years. Enrolment: 25.
Status: Ongoing, recruiting. Start date (EU): 2025-07-17. Decision date: 2024-03-13. Results received: No. Last updated: 2025-10-21.
Decision dates by country: AT: 2024-03-25, DK: 2024-03-13, DE: 2024-03-15, IT: 2024-03-15, NL: 2024-03-13, ES: 2024-03-14

Condition(s): AML
Product: Vyxeos Liposomal 44 mg/100 mg powder for concentrate for solution for infusion., Evoltra 1 mg/ml concentrate for solution for infusion

Primary endpoint: Frequency of Dose-limiting toxicities (DLTs) during the first course of therapy
Endpoint(s): 1. Safety and tolerability: frequency of AEs, frequency of clinically significant laboratory abnormalities and number of toxic deaths 2. Measures of anti-leukemic activity3. Overall patient survival and relapse-free survival 4. Number of patients undergoing HSCT after treatment. 5. Serum and intracellular pharmacokinetic parameters 6. Relationship between response (ORR) and Ara-CTP accumulation 7.Correlation between duration of response and measurable residual disease assessed by flow-cytometry

Source: https://euclinicaltrials.eu/ctis-public/view/2023-508050-26-00